EU clinical trial 2023-507027-37-00: A study to characterize the pharmacokinetic profile of norucholic acid (NCA) in patients with primary sclerosing cholangitis (PSC)
Protocol code: NUC-011/BIO
Sponsor: Dr. Falk Pharma GmbH (Pharmaceutical company). Phase: Human Pharmacology (Phase I)- Other. Countries: Germany (ended), Austria (ended), Finland (ended), Norway (ended).
Therapeutic area(s): Diseases [C] - Digestive System Diseases [C06]
Gender: Female, Male. Age: 18-64 years, 65+ years. Enrolment: 33.
Status: Ended. Start date (EU): 2023-07-20. End date (EU): 2024-11-29. End date: 2024-12-13. Decision date: 2023-12-01. Results received: No. Last updated: 2024-09-15.
Decision dates by country: AT: 2023-12-11, DE: 2023-12-01, NO: 2024-06-10, FI: 2024-07-04

Condition(s): Primary Sclerosing Cholangitis (PSC)

Source: https://euclinicaltrials.eu/ctis-public/view/2023-507027-37-00